EU clinical trial 2024-512034-14-00: TRAUMADORNASE A Prospective, Randomized Multicenter, Double Blind Clinical Trial Comparing Inhaled Dornase Alfa and Its Placebo to Reduce the Incidence of Moderate to Severe ARDS in Ventilated Trauma Patients in the Intensive Care Unit
Protocol code: 6998
Sponsor: Les Hopitaux Universitaires De Strasbourg (Hospital/Clinic/Other health care facility). Phase: Therapeutic confirmatory (Phase III). Countries: France (ongoing, recruiting).
Therapeutic area(s): Diseases [C] - Respiratory Tract Diseases [C08]
Gender: Female, Male. Age: 18-64 years, 65+ years. Enrolment: 500.
Status: Ongoing, recruiting. Start date (EU): 2019-03-04. Decision date: 2024-05-28. Results received: No. Last updated: 2026-06-15.

Condition(s): severe trauma
Product: PULMOZYME 2500 U/2,5 ml, solution pour inhalation par nébuliseur, SODIUM CHLORIDE

Primary endpoint: Incidence of moderate to severe ARDS (PaO2/FiO2 ≤ 200 or SpO2/FiO2 ≤ 235 if SpO2 ≤ 97%), according to the 2024 global definition in severe trauma patients (Injury Severity Score > 15).

Source: https://euclinicaltrials.eu/ctis-public/view/2024-512034-14-00